EU clinical trial 2024-518736-37-00: The Optimal Anticoagulation for Enhanced Risk Patients Post-Catheter Ablation for Atrial Fibrillation Trial
Protocol code: OHIRC-20150866
Sponsor: University Of Ottawa Heart Institute (Educational Institution). Phase: Therapeutic use (Phase IV). Countries: Germany (ended), Belgium (ended).
Therapeutic area(s): Diseases [C] - Cardiovascular Diseases [C14]
Gender: Female, Male. Age: 18-64 years, 65+ years. Enrolment: 282.
Status: Ended. Start date (EU): 2018-01-12. End date (EU): 2025-06-17. End date: 2025-08-14. Decision date: 2024-11-19. Results received: Yes. Last updated: 2024-11-19.
Decision dates by country: BE: 2024-11-19, DE: 2024-11-19

Condition(s): Risk of stroke by Atrial Fibrillation
Product: ASS-ratiopharm® 100 mg TAH Tabletten, Xarelto 15 mg film-coated tablets

Primary endpoint: The primary outcome is a composite of stroke, systemic embolism, and covert embolic stroke as defined by assessment of cerebral magnetic resonance imaging.
Endpoint(s): 1. Clinical, overt stroke, 2. Incidence of one or more covert MRI stroke(s) > 15 mm, 3. Composite of all major and minor bleeding, 4. Major bleeding only, 5. Minor bleeding only, 6. Intracranial hemorrhage, 7. Transient ischemic attack, 8. All-cause mortality, 9. Net clinical benefit based on reduction in stroke/TIA rate compared to major bleeding events, 10. Occurrence of non-primary endpoint MRI changes from baseline to final scan, 11. Neuropsychological testing, 12. Quality of life assessment, 13. Cost utilization and cost effectiveness analysis

Source: https://euclinicaltrials.eu/ctis-public/view/2024-518736-37-00